EU clinical trial 2024-512289-33-00: A PHASE III STUDY OF JR-141 IN MUCOPOLYSACCHARIDOSIS TYPE II (HUNTER SYNDROME) PATIENTS
Protocol code: JR-141-GS31
Sponsor: Jcr Pharmaceuticals Co. Ltd. (Pharmaceutical company). Phase: Therapeutic confirmatory (Phase III). Countries: Italy (ended), Spain (ended), Germany (ongoing, recruitment ended), Poland (ongoing, recruitment ended), France (ongoing, recruitment ended).
Therapeutic area(s): Diseases [C] - Congenital, Hereditary, and Neonatal Diseases and Abnormalities [C16]
Gender: Female, Male. Age: 0-17 years, 18-64 years. Enrolment: 35.
Start date (EU): 2022-08-24. Decision date: 2024-08-08. Results received: No. Last updated: 2026-03-11.
Decision dates by country: IT: 2024-09-30, ES: 2024-08-13, DE: 2024-08-08, PL: 2024-08-08, FR: 2024-08-09

Condition(s): Mucopolysaccharidosis type II, Hunter Syndrome
Product: JR-141, Elaprase 2 mg/ml concentrate for solution for infusion

Primary endpoint: Change in the raw scores from baseline to Week 105 measured by the BSID-III (cognitive domain) in Cohort A, Change in levels of CSF HS from baseline to Week 53 in Cohort A
Endpoint(s): Change in the age equivalent scores measured by the BSID-III (cognitive domain) or KABC-II (NVI) from baseline to Week 105 in Cohort A, Change in the age equivalent scores of adaptive behavior measured by the VABS-II -from baseline to Week 105 in Cohort A, Relative change in liver volume relative to body weight from baseline to Week 53 in Cohort A and Cohort B, Relative change in spleen volume relative to body weight from baseline to Week 53 in Cohort A and Cohort B, Relative change in distance walked using the 6-minute walk test from baseline to Week 53 in Cohort B, Gross and fine motor skills evaluated by age equivalent scores (VABS-II motor skills domain and BSID-III motor domain) from baseline to Week 26, Week 53, Week 78 and Week 105 for Cohort A., Pulmonary assessment by absolute forced vital capacity (FVC) change from baseline to Week 26 and Week 53 in Cohort B., Ongoing assessment of adverse events (AEs)., Periodical assessment of laboratory tests (hematology, blood biochemistry, iron-related tests, and urinalysis); vital signs (pulse rate, body temperature, and blood pressure); 12-lead electrocardiogram (ECG); antibodies (anti-IDS antibodies and anti-JR 141 antibodies), and infusion-associated reactions (IARs), Plasma drug concentration (only in JR-141 groups): Week 1, Week 26, Week 53, and Week 104 for Cohort A and Week 1, Week 26, and Week 52 for Cohort B., Plasma PK parameters (only in JR-141 groups): Week 1, Week 26, Week 53, and Week 104 for Cohort A and Week 1, Week 26, and Week 52 for Cohort B., Drug concentration in CSF of 16 patients in the JR-141 group of Cohort A and Cohort B, at baseline and Week 26., Frequency of treatment-emergent adverse events (TEAEs) including infusion-associated reactions (IARs) over the period of the study., Incidence of clinically significant laboratory tests; vital signs; 12-lead electrocardiogram (ECG); antibodies (anti-IDS antibodies and anti-JR 141 antibodies) over the period of the study.

Source: https://euclinicaltrials.eu/ctis-public/view/2024-512289-33-00